EU clinical trial 2023-507732-20-00: A randomized double blind, multicenter trial to assess time-interval between cytoreductive surgery and adjuvant chemotherapy after administration of local anesthetic intraperitoneally/perioperatively in advanced epithelial ovarian cancer - IPLA-OVCA
Sponsor: Karolinska University Hospital (Hospital/Clinic/Other health care facility). Phase: Therapeutic confirmatory (Phase III). Countries: Sweden (ongoing, recruitment ended).
Therapeutic area(s): Diseases [C] - Neoplasms [C04]
Gender: Female. Age: 18-64 years, 65+ years. Enrolment: 220.
Status: Ongoing, recruitment ended. Start date (EU): 2019-11-29. Decision date: 2023-08-30. Results received: No. Last updated: 2026-01-23.

Condition(s): Advanced epithelial ovarian cancer stage III-IV
Product: SODIUM CHLORIDE, ROPIVACAINE HYDROCHLORIDE

Primary endpoint: Time (days) to start of adjuvant chemotherapy after cytoreductive surgery
Endpoint(s): Postoperative complications, postoperative morbidity, quality of recovery, cardiac and renal impairment and overall survival

Source: https://euclinicaltrials.eu/ctis-public/view/2023-507732-20-00